EU clinical trial 2025-522291-83-00: A Phase 3, Multicenter, Randomized, Double-Masked, Vehicle-Controlled, Study to Demonstrate Efficacy and Safety of DFL24498 Eye Drop Solution in Adult Participants with Atopic Keratoconjunctivitis (AKC)
Protocol code: ICY-AKC-301
Sponsor: Dompe' Farmaceutici S.p.A. (Pharmaceutical company). Phase: Therapeutic confirmatory (Phase III). Countries: Spain (ongoing, recruiting), Italy (ongoing, recruiting).
Therapeutic area(s): Diseases [C] - Eye Diseases [C11]
Gender: Female, Male. Age: 18-64 years, 65+ years. Enrolment: 104.
Status: Ongoing, recruiting. Start date (EU): 2025-11-27. Decision date: 2025-11-12. Results received: No. Last updated: 2026-08-06.
Decision dates by country: ES: 2025-11-17, IT: 2025-11-12

Condition(s): Atopic Keratoconjunctivitis
Product: Isocyclosporin A, Placebo (Vehicle) for investigational DFL24498, DEXAMETHASONE

Primary endpoint: Change from baseline at week 6 in ocular itching score assessed by visual analog scale (VAS).
Endpoint(s): Change from baseline at week 6 in corneal epithelial fluorescein staining, scored by modified Oxford scale, in the study eye, Change from baseline at week 6 in bulbar conjunctival hyperemia assessed by Validated Bulbar Redness (VBR) 10 scale (0 to 100), in the study eye.

Source: https://euclinicaltrials.eu/ctis-public/view/2025-522291-83-00